EU clinical trial 2024-515157-17-00: An Open-Label, Single-arm Study to Evaluate the Pharmacokinetics (PK), Pharmacodynamics (PD), Safety, and Efficacy of Gefurulimab in Pediatric Patients (6 to < 18 years of age) with Generalized Myasthenia Gravis (gMG) Who Express Acetylcholine Receptor Antibodies (AChR+)
Protocol code: ALXN1720-MG-302
Sponsor: Alexion Pharmaceuticals Inc. (Pharmaceutical company). Phase: Therapeutic confirmatory (Phase III). Countries: Poland (ongoing, recruiting).
Therapeutic area(s): Diseases [C] - Immune System Diseases [C20]
Gender: Female, Male. Age: 0-17 years. Enrolment: 4.
Status: Ongoing, recruiting. Start date (EU): 2025-12-22. Decision date: 2025-03-24. Results received: No. Last updated: 2026-06-18.

Condition(s): Generalized Myasthenia Gravis with autoantibodies against acetylcholine receptor (AChR)
Product: Gefurulimab

Primary endpoint: Primary PK Estimand: Variables: Serum gefurulimab concentrations from Day 1 predose through Week 18 predose (Cmax, Ctrough) Summary measures: Summary statistics of gefurulimab concentrations at Day 1 predose through Week 18 predose Primary PD Estimand: Variables: Serum free C5 concentrations from Day 1 predose through Week 18 predose Summary measures: Summary statistics of serum free C5 concentrations at Day 1 predose through Week 18 predose
Endpoint(s): • Serum total C5 concentrations from Day 1 predose through Week 18 predose • Incidence of TEAEs and TESAEs • Change from Baseline in vital signs, ECG, physical examination, and laboratory assessments • Tolerability of the subcutaneous injection, "• Change from Baseline in QMG total score from Baseline through Week 18 • Proportion of participants with ≥ 5-point reduction compared to Baseline in the QMG total score over time through Week 18 • Change in MG-ADL total score from Baseline through Week 18 • Proportion of participants with ≥ 3-point reduction compared to Baseline in the MG-ADL total score over time through Week 18"

Source: https://euclinicaltrials.eu/ctis-public/view/2024-515157-17-00